EU clinical trial 2024-516360-29-00: A Multi-Center, Open-Label, Single-Arm, Phase 2 Study to Evaluate the Safety, Tolerability, and Pharmacokinetics of Vabomere (meropenem-vaborbactam) in the Treatment of Children with Complicated Urinary Tract Infection, Including Acute Pyelonephritis
Protocol code: ML-VAB-201-3248-2
Sponsor: Rempex Pharmaceuticals Inc. (Pharmaceutical company). Phase: Therapeutic exploratory (Phase II). Countries: Poland (ended), Spain (ended), Belgium (ended), Bulgaria (ongoing, recruitment ended), Greece (ongoing, recruitment ended), Croatia (ended).
Therapeutic area(s): Diseases [C] - Bacterial Infections and Mycoses [C01]
Gender: Female, Male. Age: 0-17 years. Enrolment: 51.
Start date (EU): 2025-04-25. Decision date: 2025-03-18. Results received: No. Last updated: 2026-03-13.
Decision dates by country: ES: 2025-03-18, BE: 2025-03-19, BG: 2025-03-21, HR: 2025-03-24, GR: 2025-03-19, PL: 2025-03-24

Condition(s): Complicated Urinary Tract Infection (cUTI), Acute Pyelonephritis (AP)
Product: Meropenem-Vaborbactam

Primary endpoint: Safety and tolerability based on adverse events (AEs), serious adverse events (SAEs), adverse events of special interest (AESIs), clinical laboratory (hematology, clinical chemistry, and urinalysis) changes from baseline, and vital sign changes from baseline
Endpoint(s): 1. PK: - Plasma from each blood draw will be used to estimate population PK parameters, including Cmax, Cmin, Tmax, t1/2, AUC0-8, AUC0-inf, Vss, Vz, and CL for meropenem and vaborbactam, 2. Efficacy: o Overall response (combined per-subject clinical cure and favorable microbiological response, as defined below) o Clinical cure: complete resolution or significant improvement of signs and symptoms of cUTI or AP present at baseline, no new symptoms, and subject is alive, 3. Efficacy: o Favorable microbiological response (microbiological eradication): reduction of baseline pathogen(s) (< 10˄3 CFU/mL and at least 1-log reduction from baseline) or negative urine culture, negative repeated blood culture if blood culture was positive for pathogen(s) growth at baseline, and subject is alive.

Source: https://euclinicaltrials.eu/ctis-public/view/2024-516360-29-00